EU clinical trial 2023-506367-33-00: A study in healthy people to compare two different tablets of BI 685509 and to test how food and esomeprazole influence the amount of BI 685509 in the blood
Protocol code: 1366-0042
Sponsor: Boehringer Ingelheim International GmbH (Pharmaceutical company). Phase: Human Pharmacology (Phase I)- Other. Countries: Germany (ended).
Therapeutic area(s): Not possible to specify
Gender: Female, Male. Age: 18-64 years. Enrolment: 16.
Status: Ended. Start date (EU): 2024-01-16. End date (EU): 2024-03-14. Decision date: 2023-12-07. Results received: No. Last updated: 2024-03-11.

Condition(s): Healthy volunteer trial

Source: https://euclinicaltrials.eu/ctis-public/view/2023-506367-33-00